EU clinical trial 2024-517679-18-00: Effect of proton pump inhibitors on the structural integrity of endoscopic sleeve gastroplasty: a single-centre open-label, randomized, controlled pilot clinical trial
Protocol code: E S G I S
Sponsor: Fondazione Policlinico Universitario Agostino Gemelli IRCCS (Hospital/Clinic/Other health care facility). Phase: Therapeutic use (Phase IV). Countries: Italy (ongoing, recruiting).
Therapeutic area(s): Diseases [C] - Nutritional and Metabolic Diseases [C18]; Diseases [C] - Digestive System Diseases [C06]
Gender: Female, Male. Age: 18-64 years, 65+ years. Enrolment: 40.
Status: Ongoing, recruiting. Start date (EU): 2024-02-09. Decision date: 2024-12-02. Results received: No. Last updated: 2024-12-02.

Condition(s): obesity
Product: ESOMEPRAZOLE, ESOMEPRAZOLE

Primary endpoint: the assess the effect of PPIs on the proportion of patients with “Intact ESG”, “open ESG” and “partially intact ESG” at 6 months of follow-up
Endpoint(s): to assess the effect of PPI on the proportion of patients with “intact ESG”, “partially intact ESG” and “open ESG”, separately, at 12 months of follow-up.

Source: https://euclinicaltrials.eu/ctis-public/view/2024-517679-18-00